EU clinical trial 2024-514543-28-00: Effect of Influenza Vaccination on Global Systemic Inflammatory Markers in Patients With Stable Coronary Artery Disease - Randomized Delayed-Start Pilot Trial
Protocol code: IVAMI
Sponsor: Centre Hospitalier Regional Universitaire De Tours (Hospital/Clinic/Other health care facility). Phase: Therapeutic exploratory (Phase II). Countries: France (ongoing, recruitment ended).
Therapeutic area(s): Diseases [C] - Cardiovascular Diseases [C14]
Gender: Female, Male. Age: 65+ years. Enrolment: 50.
Status: Ongoing, recruitment ended. Start date (EU): 2024-10-21. Decision date: 2024-09-16. Results received: No. Last updated: 2024-09-16.

Condition(s): patients with stable coronary artery disease
Product: VAXIGRIPTETRA, suspension injectable en seringue préremplie Vaccin grippal quadrivalent (inactivé, à virion fragmenté)

Primary endpoint: The primary outcome will be plasma high-sensitivity C-reactive protein (hsCRP) concentration. HsCRP will be measured at inclusion (basal value before vaccination) and at the end of the study (1 month). The variation in the HsCRP value will be compared between the group of subjects vaccinated just after inclusion (intervention group, “immediate” vaccination) and the group of subjects vaccinated at 1 month (control group, “follow-up” vaccination).
Endpoint(s): 1) Plasma concentration of inflammatory markers of CVD risk: interleukin (IL)-6, IL-1b, and tumor necrosis factor-α), NT-pro-BNP, fibrinogen., 2) Plasma concentration of arterial vulnerability markers: Apolipoprotein B, lipoprotein(a), LDL., 3) Characterization of circulating immune cells: - Expression level of genes involved in the T cell response (CD3, CD4, CD8) and in its Th1 (Tbet), Th2 (GATA3), Th17 (RORγ), Treg (FOXP3) orientation analyzed by an RT- technique qPCR. - Percentage of B lymphocytes (CD45+CD19+), T lymphocytes (CD45+CD3+), and monocytes (CD45+CD14+CD11c+) among PBMCs determined by flow cytometry., 4) Antibody titer at 1 month measured by the hemagglutination inhibition titer for each strain of the vaccine.

Source: https://euclinicaltrials.eu/ctis-public/view/2024-514543-28-00